EU clinical trial 2022-502227-22-00: A Phase 2b, Randomized, Controlled Double-blind, Multicenter Study Comparing the Efficacy and Safety of Zetomipzomib (KZR-616) 30 mg or 60 mg with Placebo in Patients with Active Lupus Nephritis
Protocol code: KZR-616-202
Sponsor: Kezar Life Sciences Inc. (Pharmaceutical company). Phase: Therapeutic exploratory (Phase II). Countries: Portugal (ended), Germany (ended), Greece (ended), Italy (ended), Croatia (ended), Spain (ended), France (ended).
Therapeutic area(s): Diseases [C] - Immune System Diseases [C20]
Gender: Female, Male. Age: 18-64 years, 65+ years. Enrolment: 82.
Status: Ended. Start date (EU): 2023-10-25. End date (EU): 2024-10-17. End date: 2024-11-08. Decision date: 2023-09-15. Results received: Yes. Last updated: 2024-04-24.
Decision dates by country: FR: 2023-09-19, IT: 2023-09-28, DE: 2023-09-19, GR: 2023-09-25, PT: 2023-09-18, ES: 2023-09-15, HR: 2023-10-02

Condition(s): Autoimmune disease
Product: METHYLPREDNISOLONE, Myfenax 500 mg film-coated tablets, Myfenax 500 mg film-coated tablets, Sterile Water For Injection, 0.92 mL (Prefilled Syringe), sterilized lyophilized powder with no active, Methylprednisolon acis 1000 mg Pulver und Lösungsmittel zur Herstellung einer Injektions- bzw. Infusionslösung, ZETOMIPZOMIB (KZR-616)

Primary endpoint: The primary efficacy endpoint is the proportion of patients achieving CRR at Week 37.
Endpoint(s): The key secondary efficacy endpoints will evaluate the proportion of patients achieving the following: • PRR at Week 25, Week 37, and Week 53 • CRR at Week25 and Week 53 The other secondary efficacy endpoints include the following: • Percentage change from Baseline in UPCR by visit • Time to event (CRR, PRR, death or renal event), • Proportion of patients achieving CRR (at Weeks 25, 37, and 53) with successful taper of prednisone or equivalent by Week 17 • Proportion of patients achieving CRR (at Weeks 25, 37, and 53) with no use of prednisone or equivalent during the 8 weeks prior to the renal response assessment • Proportion of patients with UPCR ≤0.5 at Weeks 13, 25, 37, and 53, • Proportion of patients achieving CRR with UPCR ≤ upper limit of normal (ULN) at Weeks 25, 37, and 53 • Change from Baseline in clinical Systemic Lupus Erythematosus Disease Activity Index 2000 (SLEDAI-2K) score, excluding complement and anti-dsDNA components • Change from Baseline in EuroQol 5-Dimension 5-Level (EQ-5D-5L)

Source: https://euclinicaltrials.eu/ctis-public/view/2022-502227-22-00